EU clinical trial 2023-509793-38-00: Ibrutinib for the Treatment of Autoimmune Hemolytic Anemia in Patients with Chronic Lymphocytic Leukemia/Small Lymphocytic Lymphoma or CLL-like monoclonal B-cell lymphocytosis. CLL2323
Protocol code: CLL2323
Sponsor: Fondazione Gimema Franco Mandelli Onlus (Health care). Phase: Therapeutic exploratory (Phase II). Countries: Italy (ongoing, recruiting).
Therapeutic area(s): Diseases [C] - Hemic and Lymphatic Diseases [C15]
Gender: Female, Male. Age: 18-64 years, 65+ years. Enrolment: 45.
Status: Ongoing, recruiting. Start date (EU): 2023-11-24. Decision date: 2024-07-23. Results received: No. Last updated: 2026-08-07.

Condition(s): Chronic Lymphocytic Leukemia/Small Lymphocytic Lymphoma or CLL-like monoclonal B-cell lymphocytosis
Product: IBRUTINIB

Primary endpoint: The primary endpoint of this study is to assess AIHA ORR after 6 cycles of therapy (28-day cycles).
Endpoint(s): AIHA ORR after 3 and 12 cycles of therapy (28-day cycles)., AIHA response duration (measured from the achievement of CR or PR to the loss of response)., AIHA-specific relapse-free survival (RFS)., Frequency of packed red blood cell (PRBC) transfusion while receiving ibrutinib., Rate of patients needing further AIHA-directed treatment during ibrutinib therapy., Incidence and type of treatment-related toxicity., CLL ORR, PR and CR rate after 3, 6 and 12 cycles of therapy (28-day cycles). CLL response is defined according to IWCLL guidelines (1)., Duration of CLL response., CLL-specific EFS., CLL-specific PFS., Overall OS. OS will be evaluated both in the entire cohort and in the CLL/SLL cohort (excluding patients with CLL-like MBL)., Quality of Life at baseline and after 3, 6 and 12 cycles of therapy (28-day cycles), Number and percentage of T-cell subsets in peripheral blood at baseline and after 6 and 12cycles of therapy (28-day cycles)., Percentage of T cells expressing activation markers and checkpoint molecules at baseline and after 6 and 12 cycles of therapy (28-day cycles)., Serum concentration of T-cell related cytokines at baseline and after 6 and 12 cycles of therapy (28-day cycles).

Source: https://euclinicaltrials.eu/ctis-public/view/2023-509793-38-00